EU clinical trial 2024-511930-11-00: A single-center blinded crossover study investigating the efficacy of apixaban in patients with painful venous malformations with localized intravascular coagulation
Sponsor: Oslo University Hospital HF (Hospital/Clinic/Other health care facility). Phase: Therapeutic exploratory (Phase II). Countries: Norway (ongoing, recruiting).
Therapeutic area(s): Diseases [C] - Cardiovascular Diseases [C14]; Diseases [C] - Hemic and Lymphatic Diseases [C15]
Gender: Female, Male. Age: 18-64 years, 65+ years. Enrolment: 24.
Status: Ongoing, recruiting. Start date (EU): 2025-04-15. Decision date: 2024-07-22. Results received: No. Last updated: 2026-01-30.

Condition(s): Venous malformation
Product: Teva GmbH filmovertrukne tabletter 5 mg

Primary endpoint: Difference between apixaban and placebo in change of self-reported pain intensity before and 8 weeks after starting treatment
Endpoint(s): Difference between apixaban and placebo in change in coagulation parameters before and 8 weeks after starting treatment (Part 1), Difference between apixaban and placebo in change of quality of life before and 8 weeks after starting treatment (Part 1), Difference between apixaban and placebo in change of amount of thrombi in venous malformation before and after 8 weeks of treatment (Part 1), Change in pain intensity and quality of life three months after reducing dose (Part 2), Registering number and severity of bleeding episodes under treatment with apixaban and placebo (Part 1 and 2), Change in pain intensity 3 months after continuing apixaban 5 mg twice daily (Part 2)

Source: https://euclinicaltrials.eu/ctis-public/view/2024-511930-11-00